EU clinical trial 2022-500031-37-00: RADAR: A randomised phase III trial with a PET response adapted design comparing ABVD +/- ISRT with A2VD +/- ISRT in patients with previously untreated stage IA/IIA Hodgkin lymphoma
Protocol code: UCL/15/0105
Sponsor: University College London (Educational Institution). Phase: Therapeutic confirmatory (Phase III). Countries: Denmark (ongoing, recruiting), Belgium (ongoing, recruiting), Portugal (ongoing, recruiting), Netherlands (ongoing, recruiting), Spain (ongoing, recruiting), Ireland (ongoing, recruiting), Slovakia (ongoing, recruiting).
Therapeutic area(s): Diseases [C] - Neoplasms [C04]
Gender: Female, Male. Age: 18-64 years, 65+ years. Enrolment: 289.
Status: Ongoing, recruiting. Start date (EU): 2024-04-08. Decision date: 2023-07-18. Results received: No. Last updated: 2025-06-23.
Decision dates by country: SK: 2024-08-22, DK: 2023-07-18, IE: 2024-11-11, NL: 2023-07-24, ES: 2023-07-18, BE: 2023-07-19, PT: 2024-09-16

Condition(s): stage IA/IIA Hodgkin lymphoma
Product: Vinblastine Sulfate 1 mg/ml solution for injection, ADCETRIS 50 mg powder for concentrate for solution for infusion, Bleomycin 15000 IU Powder for solution for injection/ infusion, Dacarbazine medac 1000 mg, powder for solution for infusion, Dacarbazine medac 100 mg, powder for solution for injection/infusion, FILGRASTIM, Dacarbazine medac 500 mg, powder for solution for infusion, Dacarbazine medac 200 mg, powder for solution for injection/infusion, Doxorubicin hydrochloride 2 mg/ml solution for infusion

Primary endpoint: Progression-Free Survival (PFS)
Endpoint(s): PET Complete Metabolic Response (CMR) rate after 2 cycles of ABVD/ A2VD, Event-Free Survival (EFS), Overall survival (OS), Incidence of second cancers and cardiovascular disease, Safety and toxicity of ABVD and A2VD as assessed by CTCAE v5.0

Source: https://euclinicaltrials.eu/ctis-public/view/2022-500031-37-00